EU clinical trial 2023-509661-21-00: Bio-equivalence of Rosuvastatin 10 mg
Sponsor: Erasmus Universitair Medisch Centrum Rotterdam (Erasmus MC) (Hospital/Clinic/Other health care facility). Phase: Human Pharmacology (Phase I)- Bioequivalence Study. Countries: Netherlands (ended).
Therapeutic area(s): Diseases [C] - Cardiovascular Diseases [C14]
Gender: Female, Male. Age: 18-64 years, 65+ years. Enrolment: 12.
Status: Ended. Start date (EU): 2024-10-03. End date (EU): 2026-06-21. Decision date: 2024-08-21. Results received: No. Last updated: 2026-02-04.

Condition(s): Healthy volunteers

Source: https://euclinicaltrials.eu/ctis-public/view/2023-509661-21-00